EU clinical trial 2024-516638-36-00: START : A randomized phase 2 study in patients with triple-negative, androgen receptor positive locally recurrent (unresectable) or metastatic breast cancer treated with darolutamide or capecitabine
Protocol code: UC-0140/1711_UCBG3
Sponsor: Unicancer (Hospital/Clinic/Other health care facility). Phase: Therapeutic exploratory (Phase II). Countries: France (ongoing, recruitment ended).
Therapeutic area(s): Diseases [C] - Neoplasms [C04]
Gender: Female. Age: 18-64 years, 65+ years. Enrolment: 1.
Status: Ongoing, recruitment ended. Start date (EU): 2018-03-14. Decision date: 2024-08-27. Results received: No. Last updated: 2024-08-27.

Condition(s): Triple-negative androgen receptor positive (molecular apocrine-like HER2-negative subtype) locally recurrent (unresectable) or metastatic breast cancer.
Product: CAPECITABINE, CAPECITABINE, NUBEQA 300 mg film-coated tablets

Primary endpoint: For each arm (Arm n°1: darolutamide / Arm n°2: capecitabine): The primary endpoint is based on clinical benefit rate at 16 weeks. The clinical benefit rate (CBR) is the measurement of all patients who have a complete response (CR), partial response (PR) or stable disease (SD) at 16 weeks (CBR16) according to RECIST v1.1
Endpoint(s): Efficacy : Clinical benefit rate at 24 weeks (CBR24), Efficacy: Objective response rate (ORR) at 16 and 24 weeks: The Objective response is defined as complete response (CR) or partial response (PR) according to RECIST v1.1., Efficacy: Duration of overall response (DoR) at 16 and 24 weeks: The DoR is defined as the time from documentation of tumour response (CR/PR) to disease progression, according to RECIST v1.1., Efficacy: Overall Survival (OS) at 1 and 2 years: The OS is defined as the time from the first administration of treatment to death from any cause., Efficacy: Progression-free survival (PFS) at 1 and 2 years: The PFS is defined as the time from the first administration of treatment to progression or death of any cause, whichever occurs first., Safety: Evaluation of Toxicity in each arm Safety will be evaluated by type, frequency and severity of adverse drug reactions according to NCI-CTC (v4.03): In order to be considered evaluable for toxicity, patients should have received at least one dose of treatment.

Source: https://euclinicaltrials.eu/ctis-public/view/2024-516638-36-00